EU clinical trial 2024-518448-20-00: DPDIMP#1-trial: Impact of DPYD gene test on the safety and efficacy of fluoropyrimidine therapy
Sponsor: HUS-Yhtymae (Hospital/Clinic/Other health care facility). Phase: Phase III and phase IV (Integrated). Countries: Finland (ended).
Therapeutic area(s): Diseases [C] - Neoplasms [C04]
Gender: Female, Male. Age: 18-64 years, 65+ years. Enrolment: 1000.
Status: Ended. Start date (EU): 2019-10-17. End date (EU): 2025-03-17. Decision date: 2024-10-29. Results received: No. Last updated: 2024-10-29.

Condition(s): Breast cancer, Colon cancer
Product: Teysuno 15 mg/4.35 mg/11.8 mg hard capsules, Capecitabine Orion 150 mg kalvopäällysteiset tabletit, Fluorouracil Accord 50 mg/ml injektio-/infuusioneste, liuos

Primary endpoint: The concentrations of fluorouracil, tegafur, and capecitabine and their metabolites and pharmacokinetic variables in plasma and fingertip capillary blood samples.

Source: https://euclinicaltrials.eu/ctis-public/view/2024-518448-20-00